EU clinical trial 2025-521001-40-00: A clinical trial to learn how liver function affects the blood levels of DAK539 in people with advanced cancer
Protocol code: CDAK539A12103
Sponsor: Novartis Pharma AG (Pharmaceutical company). Phase: Human Pharmacology (Phase I)- Other. Countries: Spain (ongoing, recruiting), France (authorised, recruitment pending), Italy (authorised, recruitment pending).
Therapeutic area(s): Diseases [C] - Neoplasms [C04]
Gender: Female, Male. Age: 18-64 years, 65+ years. Enrolment: 19.
Start date (EU): 2026-07-10. Decision date: 2026-04-09. Results received: No. Last updated: 2026-04-13.
Decision dates by country: FR: 2026-04-10, IT: 2026-04-09, ES: 2026-04-13

Condition(s): Advanced Malignancies and Hepatic Impairment

Source: https://euclinicaltrials.eu/ctis-public/view/2025-521001-40-00